EU clinical trial 2024-520127-89-00: GASPS Study: General Anaesthesia vs Spinal anaesthesia: Patient outcomes and Success in Outpatient primary total knee and hip Arthroplasty
Protocol code: GASPS
Sponsor: Region Oerebro Laen (Hospital/Clinic/Other health care facility). Phase: Therapeutic use (Phase IV). Countries: Sweden (authorised, recruitment pending).
Therapeutic area(s): Analytical,Diagnostic,Therapeutic Techniques and Equipment [E]-Surgical Procedures, Operative [E04]
Gender: Female, Male. Age: 18-64 years, 65+ years. Enrolment: 600.
Status: Authorised, recruitment pending. Decision date: 2026-03-12. Results received: No. Last updated: 2026-03-12.

Condition(s): Total knee and hip arthroplasties
Product: REMIFENTANIL, PROPOFOL, BUPIVACAINE, SUFENTANIL, FENTANYL

Primary endpoint: Successful same-day discharge, defined as: • The patient is discharged from the hospital on the same day as the surgery and, • the patient is not readmitted within 48 hours of discharge.
Endpoint(s): Time from start of anaesthesia to start of surgery (Phase II)., Time from start of surgery to discharge from the postoperative recovery unit (Phase II)., Time from start of surgery to fulfilment of indicators for end phase III (intermediate recovery) as outlined in the protocol (table 4)., Time from start of surgery to discharge from hospital (Phase III)., Time from start of surgery to first successful mobilisation, assessed by the ability to walk with tolerable pain and ascend/descend stairs if applicable., Use of analgesics (opioids converted to Oral morphine equivalents (OME))., Patient-reported quality of recovery using the Swedish Version of Quality of Recovery - 15 (QoR-15) from postoperative day (POD) 1 to POD 35., Pain levels measured using the Numeric Rating Scale (NRS) during the recovery period (postoperative until discharge to ward), Knee injury and Osteoarthritis Outcome Score (KOOS) at baseline, 4 weeks, 6 months 12 months., Hip disability and Osteoarthritis Outcome Score (HOOS), at baseline, 4 weeks, 6 months 12 months., Use of analgesics (opioids converted to Oral morphine equivalents (OME)). Daily postoperative day 1-14, weekly day 15-35, Incidence, severity and frequency of adverse events (AEs) and serious adverse events (SAEs), until postoperative day 3., Incidence and frequency of predefined adverse outcomes. (Table 1), until postoperative day 3., Units of blood transfusion, until discharge from hospital, Key themes from patient-reported experiences of anaesthesia and postoperative care, gathered through semi-structured interviews conducted 14–60 days post-surgery., Incremental cost-effectiveness ratios (ICERs) comparing costs and quality-adjusted life years (QALYs) gained between GA and SA.

Source: https://euclinicaltrials.eu/ctis-public/view/2024-520127-89-00